EU clinical trial 2025-523060-20-00: A prospective, open-label, single-arm, multicenter study evaluating the efficacy of Xanomeline/Trospium (XT) on cognitive impairment after 24 and 52 weeks of treatment in adult participants with schizophrenia.
Protocol code: SHINE
Sponsor: European Group for Research in Schizophrenia Stichting (Patient organisation/association). Phase: Therapeutic confirmatory (Phase III). Countries: Denmark (not authorised), Belgium (not authorised), Italy (not authorised), Netherlands (not authorised), Hungary (not authorised), Czechia (not authorised), Austria (not authorised), Spain (not authorised), Germany (not authorised).
Therapeutic area(s): Psychiatry and Psychology [F] - Mental Disorders [F03]
Gender: Female, Male. Age: 18-64 years. Enrolment: 160.
Status: Not authorised. Decision date: 2026-03-03. Results received: No. Last updated: 2026-03-09.
Decision dates by country: AT: 2026-03-09, BE: 2026-03-06, CZ: 2026-03-09, DK: 2026-03-03, DE: 2026-03-06, HU: 2026-03-09, IT: 2026-03-04, ES: 2026-03-04, NL: 2026-03-04

Condition(s): Schizophrenia
Product: KarXT, KarXT, KarXT

Primary endpoint: Change from baseline to week 24 in the BACS composite cognitive score.
Endpoint(s): Change from baseline to week 24 in the PANSS negative subscale.

Source: https://euclinicaltrials.eu/ctis-public/view/2025-523060-20-00